EU clinical trial 2023-506912-41-00: A phase 1, randomised, double-blind, placebo-controlled, single ascending dose and multiple ascending dose study to evaluate the safety, tolerability, and pharmacokinetics in healthy adult subjects after subcutaneous injection of TISA-818-Inj-5mg/mL.
Protocol code: TISA-818-22101
Sponsor: Enlitisa (Shanghai) Pharmaceutical Co. Ltd. (Pharmaceutical company). Phase: Human Pharmacology (Phase I)- Other. Countries: Sweden (ended).
Therapeutic area(s): Diseases [C] - Respiratory Tract Diseases [C08]
Gender: Female, Male. Age: 18-64 years. Enrolment: 48.
Status: Ended. Start date (EU): 2024-01-09. End date (EU): 2024-10-16. Decision date: 2023-11-27. Results received: No. Last updated: 2023-11-27.

Condition(s): Idiopathic pulmonary fibrosis

Source: https://euclinicaltrials.eu/ctis-public/view/2023-506912-41-00